EU clinical trial 2024-511510-20-00: PNOC029_Tovorafenib for the treatment of newly diagnosed or recurrent craniopharyngioma in children and young adults
Sponsor: Prinses Maxima Centrum voor Kinderoncologie B.V. (Hospital/Clinic/Other health care facility). Phase: Therapeutic exploratory (Phase II). Countries: Netherlands (authorised, recruitment pending), France (authorised, recruitment pending), Germany (authorised, recruitment pending).
Therapeutic area(s): Diseases [C] - Neoplasms [C04]
Gender: Female, Male. Age: 0-17 years, 18-64 years. Enrolment: 16.
Status: Authorised, recruitment pending. Decision date: 2026-03-25. Results received: No. Last updated: 2026-03-30.
Decision dates by country: FR: 2026-03-30, DE: 2026-03-25, NL: 2026-03-30

Condition(s): craniopharyngioma
Product: Tovorafenib, Tovorafenib

Primary endpoint: PFS12 (progression free survival at 12 months), QOL12 (quality of life at 12 months)
Endpoint(s): Visual Responsive ≥ 0.2 logMAR improvement in VA compared to baseline, Stable VA = does not meet criteria for Improved or Worsening VA compared to baseline, Visual Progressive Disease ≥ 0.2 logMAR worsening compared to baseline, Visual field assessments with Humphrey visual field test, Presence or absence of new from baseline: hypothalamic obesity, diabetes insipidus, growth hormone deficiency, adrenal insufficiency

Source: https://euclinicaltrials.eu/ctis-public/view/2024-511510-20-00